EU clinical trial 2022-502629-16-00: A Phase 3 Randomized, Placebo-Controlled, Double-Blind, Multicenter Study to Evaluate the Efficacy and Safety of Nipocalimab in Pregnancies at Risk for Severe Hemolytic Disease of the Fetus and Newborn (HDFN).
Protocol code: 80202135EBF3001
Sponsor: Janssen - Cilag International (Pharmaceutical company). Phase: Therapeutic confirmatory (Phase III). Countries: Germany (ongoing, recruiting), Netherlands (ongoing, recruiting), Belgium (ongoing, recruiting), Italy (ongoing, recruiting), Spain (ongoing, recruiting), France (ongoing, recruiting), Sweden (ongoing, recruiting), Austria (ongoing, recruiting), Ireland (authorised, recruitment pending), Poland (authorised, recruitment pending), Czechia (authorised, recruitment pending).
Therapeutic area(s): Diseases [C] - Immune System Diseases [C20]
Gender: Female. Age: 18-64 years. Enrolment: 31.
Start date (EU): 2024-07-10. Decision date: 2024-01-18. Results received: No. Last updated: 2026-07-13.
Decision dates by country: BE: 2024-01-18, FR: 2024-01-19, DE: 2024-01-18, IT: 2024-01-18, ES: 2024-01-22, SE: 2024-01-19, NL: 2024-01-22, AT: 2024-05-06, IE: 2024-05-03, PL: 2026-04-23, CZ: 2026-03-20

Condition(s): Hemolytic Disease of the Fetus and Newborn (HDFN)
Product: JNJ-80202135, JNJ-80202135, Saline, 0.9% Sodium Chloride Solution for Injection

Primary endpoint: The proportion of pregnancies that did not result in fetal loss (due to any reason), IUT, hydrops fetalis, or neonatal death (due to any reason) during the neonatal period (through 4 weeks of age or 41 weeks PMA, whichever is later).

Source: https://euclinicaltrials.eu/ctis-public/view/2022-502629-16-00